EU clinical trial 2023-503655-10-00: SELECT-SLE: A Phase 3 Program to Evaluate the Safety and Efficacy of Upadacitinib in Subjects with Moderately to Severely Active SLE
Protocol code: M23-699
Sponsor: Abbvie Deutschland GmbH & Co. KG (Pharmaceutical company). Phase: Therapeutic confirmatory (Phase III). Countries: Belgium (ongoing, recruitment ended), Greece (ongoing, recruitment ended), France (ongoing, recruitment ended), Hungary (ongoing, recruitment ended), Portugal (ongoing, recruitment ended), Slovakia (ongoing, recruitment ended), Romania (ongoing, recruitment ended), Spain (ongoing, recruitment ended), Germany (ongoing, recruitment ended), Bulgaria (ongoing, recruitment ended), Poland (ongoing, recruitment ended), Estonia (ongoing, recruitment ended), Croatia (ongoing, recruitment ended), Latvia (ongoing, recruitment ended), Italy (ongoing, recruitment ended), Lithuania (ongoing, recruitment ended).
Therapeutic area(s): Phenomena and Processes [G] - Immune system processes [G12]
Gender: Female, Male. Age: 18-64 years. Enrolment: 250.
Status: Ongoing, recruitment ended. Start date (EU): 2023-11-20. Decision date: 2023-10-31. Results received: No. Last updated: 2026-07-27.
Decision dates by country: ES: 2023-11-02, DE: 2023-11-03, IT: 2023-11-06, PT: 2023-11-03, GR: 2023-11-01, BE: 2023-10-31, BG: 2023-11-06, LT: 2023-11-07, HR: 2023-11-03, PL: 2023-11-03, SK: 2023-11-03, FR: 2023-11-03, EE: 2023-11-06, RO: 2023-11-06, LV: 2023-11-06, HU: 2023-11-06

Condition(s): Systemic Lupus Erythematosus (SLE).
Product: Placebo for Upadacitinib, Upadacitinib, Upadacitinib

Primary endpoint: Study 1 and Study 2: The primary efficacy endpoint is the achievement of BICLA response at Week 52. As part of the additional endpoints, the achievement of BICLA response will also be assessed at all other visits collected; Study 3: There is no primary endpoint in Study 3. Study 4: There is no primary endpoint in Study 4.
Endpoint(s): Study 1 and Study 2 The ranked secondary endpoints are: Flare through Week 52. Flare is defined by the SELENA SLEDAI Flare Index (SFI)., Achievement of SRI-4 at Week 52., Achievement of LLDAS at Week 52., Time to first flare per SFI through Week 52., Achievement of oral glucocorticoid dose ≤7.5 mg prednisone-equivalent (among subjects taking ≥10 mg prednisone-equivalent at Baseline) from Week 44 to Week 52., Achievement of ≥50% improvement in tender or swollen joints (among subjects with ≥3 swollen joints and ≥6 total affected joints at Baseline) at Week 52., Achievement of ≥50% reduction in CLASI activity score (among subjects with Baseline score ≥10) at Week 52, Change from Baseline in FACIT-Fatigue v4 at Week 52., Change from Baseline in Lupus Pain NRS at Week 52., Change from Baseline in SF-36v2® Health Survey Acute PCS at Week 52 As part of the additional endpoints, the endpoints listed above (with the exception of 1, 4, and 5) will also be assessed at all other visits collected. Study 3 There are no ranked secondary endpoints in Study 3. Study 4: There are no ranked secondary endpoints in Study 4.

Source: https://euclinicaltrials.eu/ctis-public/view/2023-503655-10-00